EU clinical trial 2023-505078-13-00: AGNOSTIC THERAPY IN A PHASE II, MULTICENTER, SINGLE-ARM STUDY IN FIRST-LINE TREATMENT OF DURVALUMAB (MEDI 4736) IN ASSOCIATION WITH CARBOPLATIN OR CISPLATIN AND ETOPOSIDE IN PATIENTS AFFECTED BY EXTENSIVE STAGE - EXTRAPULMONARY SMALL CELL CARCINOMA (EPSCC) – DURVASCC TRIAL
Protocol code: GOIRC‐01‐2021
Sponsor: GOIRC Gruppo Oncologico Italiano Di Ricerca Clinica (Patient organisation/association). Phase: Therapeutic exploratory (Phase II). Countries: Italy (ongoing, recruiting).
Therapeutic area(s): Diseases [C] - Neoplasms [C04]
Gender: Female, Male. Age: 18-64 years, 65+ years. Enrolment: 66.
Status: Ongoing, recruiting. Start date (EU): 2024-01-16. Decision date: 2023-12-04. Results received: No. Last updated: 2024-12-11.

Condition(s): EXTENSIVE STAGE ‐ EXTRAPULMONARY SMALL CELL CARCINOMA
Product: CISPLATIN, CARBOPLATIN, CISPLATIN, ETOPOSIDE, IMFINZI 50 mg/mL concentrate for solution for infusion.

Primary endpoint: PFS is defined as the time from initiation of study treatment to the first occurrence of disease progression or death from any cause, whichever occurs first.
Endpoint(s): ORR is defined as the percentage of patients who attain complete response (CR) or partial response (PR) according to RECIST v1.1., DCR is measured as the percentage of patients who have achieved CR, PR and stable disease (SD), OS is defined as the time from initiation of study treatment to death from any cause., DOR is defined as the time from initial response to disease progression or death among patients who have experienced a CR or PR (unconfirmed) during the study. Duration of response will be calculated based on disease status evaluated by the investigator according to RECIST v1.1., QoL is measured as pre‐defined PRO endpoints in this study are mean change from baseline in EORTC QLQ‐C30 questionnaire administered at the enrollment time (baseline) and after the induction phase (3± 2 weeks)., Safety will be evaluated in terms of incidence, nature, frequency and severity of Adverse Events (AEs) and laboratory abnormalities graded by National Cancer Institute (NCI) Common Terminology Criteria for Adverse Events (CTCAE) v.5.0.

Source: https://euclinicaltrials.eu/ctis-public/view/2023-505078-13-00